EU clinical trial 2024-512562-34-00: A Phase Ilb, Randomized, Double-blind, Placebo-controlled and Open-label Active Comparator Study to Evaluate the Efficacy, Safety, and Tolerability of AZD5004 in Adults with Type 2 Diabetes Mellitus
Protocol code: D7261C00001
Sponsor: AstraZeneca AB (Pharmaceutical company). Phase: Therapeutic exploratory (Phase II). Countries: Hungary (ended), Germany (ended), Poland (ended), Spain (ended), Slovakia (ended).
Therapeutic area(s): Diseases [C] - Nutritional and Metabolic Diseases [C18]
Gender: Female, Male. Age: 18-64 years, 65+ years. Enrolment: 118.
Status: Ended. Start date (EU): 2025-02-24. End date (EU): 2025-12-17. End date: 2025-12-19. Decision date: 2024-11-15. Results received: No. Last updated: 2025-11-19.
Decision dates by country: DE: 2024-11-15, HU: 2024-11-22, ES: 2024-11-19, PL: 2024-11-18, SK: 2024-11-19

Condition(s): Type 2 Diabetes Mellitus
Product: AZD5004, AZD5004, AZD5004, Rybelsus 14 mg tablets, Placebo to match AZD5004 (PTM) film-coated tablets, Rybelsus 7 mg tablets, Rybelsus 3 mg tablets

Primary endpoint: Change in HbA1c from baseline to 26 weeks.
Endpoint(s): Change in fasting glucose from baseline to 4, 12, 16, and 26 weeks, Achieved HbA1c ≤ 6.5% at 26 weeks, Baseline HbA1c ≥ 7.0% and achieved HbA1c < 7.0% at 26 weeks, Percent change in body weight from baseline to 26 weeks, Absolute change in body weight (kg) from baseline to 26 weeks, Achievement of ≥ 5%, ≥ 10% and ≥ 15% weight reduction from baseline at Week 26

Source: https://euclinicaltrials.eu/ctis-public/view/2024-512562-34-00